EU clinical trial 2024-519437-27-02: A randomized phase III trial with lomustine versus lomustine and bevacizumab for patients with recurrent glioblastoma
Protocol code: English
Sponsor: Rigshospitalet (Hospital/Clinic/Other health care facility). Phase: Therapeutic confirmatory (Phase III). Countries: Denmark (ongoing, recruiting).
Therapeutic area(s): Diseases [C] - Nervous System Diseases [C10]; Diseases [C] - Neoplasms [C04]
Gender: Female, Male. Age: 18-64 years, 65+ years. Enrolment: 168.
Status: Ongoing, recruiting. Start date (EU): 2025-02-03. Decision date: 2025-01-13. Results received: No. Last updated: 2025-01-13.

Condition(s): Glioblastoma
Product: Zirabev 25 mg/ml concentrate for solution for infusion., LOMUSTINE MEDAC 40 mg, gélule

Primary endpoint: The primary endpoint is overall survival
Endpoint(s): 1) To determine the 6- and 12 months progression-free survival (PFS) 2) To determine the objective response rate (RR) and duration of response (according to RANO criteria). 3) To determine the overall survival distribution and overall survival at 12 and 18 months. 4) To determine the safety and feasibility of the combination of bevacizumab and lomustine as compared to lomustine alone.

Source: https://euclinicaltrials.eu/ctis-public/view/2024-519437-27-02